EU clinical trial 2025-524691-33-00: A multicenter, Phase Ib/II study to evaluate the safety, tolerability, pharmacokinetics and preliminary clinical activity of TUB-040, in combination with standard ovarian cancer drugs in patients with high-grade epithelial serous or endometrioid epithelial ovarian cancer (OC) (NAPISTAR 1-02)
Protocol code: NAPISTAR 1-02
Sponsor: Tubulis GmbH (Pharmaceutical company). Phase: Phase I and Phase II (Integrated)- Other. Countries: Belgium (ongoing, recruiting).
Therapeutic area(s): Diseases [C] - Female Urogenital Diseases and Pregnancy Complications [C13]; Diseases [C] - Neoplasms [C04]
Gender: Female. Age: 18-64 years, 65+ years. Enrolment: 42.
Status: Ongoing, recruiting. Start date (EU): 2026-03-09. Decision date: 2026-02-12. Results received: No. Last updated: 2026-07-24.

Condition(s): High-grade epithelial serous or endometrioid epithelial ovarian cancer
Product: TUB-040

Primary endpoint: • Occurrence and severity of treatment-emergent adverse events (TEAEs), • Occurrence of DLTs (Dose limiting toxicities) at different dose levels (during first treatment cycle)
Endpoint(s): •PK parameters of TUB-040 ADC, total mAb and free exatecan, including but not limited to maximum concentration Cmax, time to Cmax (Tmax), area under the curve (AUC) and as far as collected data allow an estimation of half-life (t1/2), • Incidence and titers of anti-drug antibodies (ADA) against TUB-040, • Objective response rate (ORR) by RECIST v1.1 assessed by Investigator (INV), • Time to first response (TTR) by RECIST v1.1 assessed by INV, • Duration of response (DoR) by RECIST v1.1 assessed by INV, • Progression-free survival (PFS) by RECIST v1.1 assessed by INV, • Number of patients with Gynecologic Cancer Intergroup (GCIG) XX-XXX criteria clinical responses, • Incidence of serious adverse events (SAEs), • Incidence of ≥Grade 3 laboratory abnormalities

Source: https://euclinicaltrials.eu/ctis-public/view/2025-524691-33-00